EU clinical trial 2023-505358-16-00: A Phase 1 Study of JNJ-87890387 for Advanced Solid Tumors
Protocol code: 87890387STM1001
Sponsor: Janssen - Cilag International (Pharmaceutical company). Phase: Human Pharmacology (Phase I)- First administration to humans. Countries: France (ongoing, recruiting), Spain (ongoing, recruiting).
Therapeutic area(s): Diseases [C] - Neoplasms [C04]
Gender: Female, Male. Age: 18-64 years, 65+ years. Enrolment: 130.
Status: Ongoing, recruiting. Start date (EU): 2024-04-11. Decision date: 2024-03-20. Results received: No. Last updated: 2026-03-27.
Decision dates by country: FR: 2024-04-02, ES: 2024-03-20

Condition(s): Advanced Solid Tumors

Source: https://euclinicaltrials.eu/ctis-public/view/2023-505358-16-00